EU clinical trial 2025-520786-44-00: A Modular Phase I/II, Open-label, Multicentre Study to Evaluate the Safety, Tolerability and Preliminary Efficacy of AZD2962, an IRAK4 inhibitor, as Monotherapy and in Combination with other Agents, in Participants with Hematologic Neoplasms
Protocol code: D7770C00001
Sponsor: AstraZeneca AB (Pharmaceutical company). Phase: Phase I and Phase II (Integrated)- First administration to humans. Countries: Spain (temporarily halted).
Therapeutic area(s): Diseases [C] - Neoplasms [C04]; Diseases [C] - Hemic and Lymphatic Diseases [C15]
Gender: Female, Male. Age: 18-64 years, 65+ years. Enrolment: 7.
Status: Temporarily halted. Start date (EU): 2025-10-21. Decision date: 2025-08-11. Results received: No. Last updated: 2025-12-10.

Condition(s): Myelodysplastic syndromes, Dysplastic chronic myelomonocytic leukaemia
Product: AZD2962, AZD2962

Primary endpoint: Incidence of DLTs during the DLT observation period., Incidence, severity, and relationship to IMP, of AEs and SAEs., Changes from baseline in laboratory evaluations, vital signs, physical examinations, and ECG results., Duration of exposure and relative dose intensity.
Endpoint(s): Objective Response, as assessed by the response criteria corresponding to the different haematologic neoplasms., Duration of Response, Time to Response, Overall Survival, and Time to progression to AML., Plasma concentrations of AZD2962., Plasma PK parameters of AZD2962 (including but not limited to AUC, Cmax, and tmax, as data allow).

Source: https://euclinicaltrials.eu/ctis-public/view/2025-520786-44-00